EU clinical trial 2024-519657-11-00: Exploratory study to evaluate the safety and tolerability of tamoxifen citrate in the treatment of cystic fibrosis in patients without mutations currently eligible for therapy with CFTR modulator drugs Protocol Code: CRCFC-TAMOXI063
Protocol code: CRCFC-TAMOXI063
Sponsor: Azienda Ospedaliera Universitaria Integrata Verona (Hospital/Clinic/Other health care facility). Phase: Therapeutic exploratory (Phase II). Countries: Italy (authorised, recruitment pending).
Therapeutic area(s): Diseases [C] - Stomatognathic Diseases [C07]; Diseases [C] - Respiratory Tract Diseases [C08]
Gender: Female, Male. Age: 18-64 years. Enrolment: 35.
Status: Authorised, recruitment pending. Decision date: 2025-06-24. Results received: No. Last updated: 2025-10-06.

Condition(s): cystic fibrosis
Product: TAMOXENE 20 mg compresse rivestite con film

Primary endpoint: The primary endpoint of this study will be evaluated by calculating between baseline and week 24 the incidence of serious adverse events (SAEs), treatment-emergent adverse events (TEAEs) and treatment discontinuation due to AEs. In addition, frequency of specific, indication-relevant adverse events (e.g., thromboembolic events, elevation of liver enzymes, pulmonary exacerbations) and cumulative AE analyses, such as the number of AEs per patient, will be also evaluated.
Endpoint(s): The secondary endpoints will evaluate the relative change from baseline to week 24 in ppFEV1, The secondary endpoints will evaluate the number of pulmonary exacerbations up to week 24, The secondary endpoints will evaluate the time to the first pulmonary exacerbation up to week 24, The secondary endpoints will evaluate the number of hospitalizations for cystic fibrosis lasting > 24 hours, The secondary endpoints will evaluate the time to the first hospitalization for cystic fibrosis, the absolute change in the respiratory domain score of the Cystic Fibrosis Questionnaire-Revised (CFQ-R) from baseline to week 24, the use of intravenous antibiotics during the study (total number of days of intravenous antibiotics for sino-pulmonary signs and symptoms up to week 24), the use of oral antibiotics during the study (total number of days of oral antibiotics for sino-pulmonary signs and symptoms up to week 24), changes in BMI from baseline to week 24, changes in sputum microbiology at the beginning and end of the study, changes in the amount of chloride measured with the sweat test at the beginning and end of the study

Source: https://euclinicaltrials.eu/ctis-public/view/2024-519657-11-00